EU clinical trial 2024-517804-12-00: Sacubitril/Valsartan in PriMAry preventIoN of the cardiotoxicity of systematic breaST canceR trEAtMent. Randomized, multicenter, double-blind, placebo-controlled study.
Protocol code: 2021/ABM/03/00008
Sponsor: Slaskie Centrum Chorob Serca W Zabrzu (Hospital/Clinic/Other health care facility). Phase: Therapeutic confirmatory (Phase III). Countries: Poland (ongoing, recruiting).
Therapeutic area(s): Diseases [C] - Cardiovascular Diseases [C14]
Gender: Female. Age: 18-64 years, 65+ years. Enrolment: 600.
Status: Ongoing, recruiting. Start date (EU): 2024-04-17. Decision date: 2024-12-02. Results received: No. Last updated: 2025-10-26.

Condition(s): Heart failure – post-anthracycline cardiomyopathy
Product: Entresto 97 mg/103 mg film-coated tablets, Entresto 49 mg/51 mg film-coated tablets, placebo Entresto 49 mg / 51mg, placebo Entresto 97 mg / 103 mg

Primary endpoint: Decrease in left ventricular ejection fraction ≥ 5% assessed on magnetic resonance imaging (MRI) in 24 months from randomisation
Endpoint(s): Death from any cause or hospitalization for heart failure, Death from any cause, Death from cardiovascular causes, Hospitalization for other cardiovascular causes, cardiotoxicity, Decrease in left ventricular ejection fraction ≥ 5% (MRI) during 24 months from randomization, Decrease in left ventricular ejection fraction ≥ 5% during 24 months from randomization, Occurrence of diastolic dysfunction (UKG) within 24 months of randomization Diastolic dysfunction assessed on echocardiography, Development of pathological pericardial fluid volume or increase in pericardial fluid volume from baseline, Occurrence of cardiac tamponade, Occurrence of pericarditis, Occurrence of myocarditis, Development of ventricular arrhythmias, Development of supraventricular arrhythmias, Presence of conduction disturbances, Changes in corrected QT interval, Changes in BNP, NT pro-BNP, troponin T or troponin I levels

Source: https://euclinicaltrials.eu/ctis-public/view/2024-517804-12-00